EU clinical trial 2025-523131-19-00: IJAMP-Trial
Sponsor: Johannes Kepler University Linz (Educational Institution). Phase: Therapeutic use (Phase IV). Countries: Austria (authorised, recruitment pending).
Therapeutic area(s): Diseases [C] - Skin and Connective Tissue Diseases [C17]
Gender: Female, Male. Age: 18-64 years, 65+ years. Enrolment: 30.
Status: Authorised, recruitment pending. Decision date: 2026-06-01. Results received: No. Last updated: 2026-06-01.

Condition(s): prick test-induced itch

Source: https://euclinicaltrials.eu/ctis-public/view/2025-523131-19-00